EU clinical trial 2024-515633-15-00: A Phase 2/3 Adaptive, Double-blind, Placebo-Controlled Study to Evaluate the Efficacy and Safety of VX-147 in Adult and Pediatric Subjects With APOL1-mediated Proteinuric Kidney Disease
Protocol code: VX21-147-301
Sponsor: Vertex Pharmaceuticals Inc. (Pharmaceutical company). Phase: Phase II and Phase III (Integrated). Countries: Belgium (ongoing, recruiting), France (ongoing, recruiting).
Therapeutic area(s): Phenomena and Processes [G] - Genetic Phenomena [G05]
Gender: Female, Male. Age: 0-17 years, 18-64 years. Enrolment: 42.
Status: Ongoing, recruiting. Start date (EU): 2022-10-25. Decision date: 2024-10-22. Results received: No. Last updated: 2026-07-20.
Decision dates by country: BE: 2024-10-22, FR: 2024-10-25

Condition(s): APOL1-mediated Proteinuric Kidney Disease (AMKD)
Product: VX-147 film-coated tablet, VX-147, Coated Placebo Tablet

Primary endpoint: Part A: Percent change in UPCR evaluated from baseline at Week 48 (assessed at the IA) • eGFR slope (with ≥48 weeks of eGFR data assessed at the IA and at least 2 years of eGFR data assessed at the final analysis), Part B: Safety and tolerability assessments based on AEs, clinical laboratory values, and vital signs
Endpoint(s): Part A: Safety and tolerability based on adverse events (AEs), clinical laboratory values (i.e., hematology, serum chemistry, urinalysis, coagulation studies), standard 12-lead ECGs, and vital signs, Part A: Plasma PK parameters of VX-147, Part A: Acceptability of tablet formulation of VX-147 in pediatric subjects using the convenience domain of the Treatment Satisfaction Questionnaire for Medication (TSQM), Part B: Percent change in UPCR from baseline over time, Part B: eGFR slope

Source: https://euclinicaltrials.eu/ctis-public/view/2024-515633-15-00